EU clinical trial 2024-511069-12-00: A randomized, double-blind, placebo controlled, 2-armmulticenter phase 3 study to assess the efficacy and safetyof ianalumab in patients with active Sjögren’s syndrome(NEPTUNUS-1)
Protocol code: CVAY736A2301
Sponsor: Novartis Pharma AG (Pharmaceutical company). Phase: Therapeutic confirmatory (Phase III). Countries: Belgium (ended), Czechia (ended), Spain (ended), Austria (ended), Poland (ended), Portugal (ended), Germany (ended), France (ended), Lithuania (ended).
Therapeutic area(s): Diseases [C] - Immune System Diseases [C20]
Gender: Female, Male. Age: 18-64 years, 65+ years. Enrolment: 128.
Status: Ended. Start date (EU): 2022-07-28. End date (EU): 2026-01-05. End date: 2026-06-02. Decision date: 2024-07-08. Results received: No. Last updated: 2026-02-23.
Decision dates by country: CZ: 2024-07-10, AT: 2024-08-12, DE: 2024-07-11, BE: 2024-07-09, FR: 2024-07-12, PL: 2024-07-15, ES: 2024-07-12, LT: 2024-07-23, PT: 2024-07-08

Condition(s): Sjögren’s Syndrome
Product: VAY736, Placebo to VAY736 150 mg/1 mL Solution for injection in pre-filled syringe

Primary endpoint: The primary efficacy endpoint is change from baseline in ESSDAI score.
Endpoint(s): ESSDAI response at Week 48, Low systemic disease activity (ESSDAI < 5), ESSPRI response, changes from baseline in sSF, changes from baseline in PhGA, changes from baseline in PaGA, changes from baseline in FACIT-F, SSSD response at Week 48, ESSDAI response at Week 24

Source: https://euclinicaltrials.eu/ctis-public/view/2024-511069-12-00